EU clinical trial 2025-521005-41-00: A three-part trial in healthy volunteers to find out how long icotrokinra stays in and acts on the body when administered as different tablet formulations and under different food conditions
Protocol code: 77242113PSO1010
Sponsor: Janssen Cilag International (Pharmaceutical company). Phase: Human Pharmacology (Phase I)- Other. Countries: Belgium (ended).
Therapeutic area(s): Diseases [C] - Immune System Diseases [C20]
Gender: Female, Male. Age: 18-64 years. Enrolment: 64.
Status: Ended. Start date (EU): 2025-06-30. End date (EU): 2026-07-16. Decision date: 2025-06-16. Results received: No. Last updated: 2026-06-02.

Condition(s): Inflammatory Conditions

Source: https://euclinicaltrials.eu/ctis-public/view/2025-521005-41-00